EU clinical trial 2024-513068-25-00: Randomized, placebo-controlled, double-blind and double-dummy clinical trial comparing the safety, tolerability, and efficacy of vigabatrin and rapamycin in a preventive treatment of infants with Tuberous Sclerosis Complex
Protocol code: ViRap
Sponsor: Instytut Pomnik Centrum Zdrowia Dziecka (Hospital/Clinic/Other health care facility). Phase: Phase II and Phase III (Integrated). Countries: Poland (ongoing, recruiting).
Therapeutic area(s): Diseases [C] - Nervous System Diseases [C10]
Gender: Female, Male. Age: 0-17 years. Enrolment: 60.
Status: Ongoing, recruiting. Start date (EU): 2021-05-20. Decision date: 2024-12-18. Results received: No. Last updated: 2025-02-25.

Condition(s): Tuberous Sclerosis Complex, Epilepsy, Tumors associated with Tuberous Sclerosis Complex
Product: SABRIL, 500 mg, granulat do sporządzania roztworu doustnego, linseed oil, lactose, Rapamune 1 mg/mL oral solution

Primary endpoint: occurrence of clinical seizures in the blinded phase of the study, increase in summarized volume of TSC-associated tumors ≥ 25% of initial value within the blinded phase of the study.
Endpoint(s): time from birth to onset of first clinical epileptic seizure, total volume of TSC-associated tumors within the blinded phase and the whole study, the risk for high risk of autism assessed with psychological test (ADOS) at the end of the study, the risk for low developmental quotient (< 70 points in Bayley Scales of Infant Development,) at the end of the study,, the risk of drug-resistant epilepsy at any point of the study, occurrence of adverse events within the blinded phase of the study,, number of adverse events across the whole study, parameters of physical development (weight and height gain history) across the whole study., Parameters of vital signs (body temperature, pulse rate, respiraton rate and blood pressure)

Source: https://euclinicaltrials.eu/ctis-public/view/2024-513068-25-00